EU clinical trial 2024-511990-31-00: A Randomized, Double-blind, Placebo-controlled, 12-month Phase 3 Study to Evaluate the Effect of Venglustat on Neuropathic and Abdominal Pain in Male and Female Participants ≥16 Years of Age with Fabry Disease who are treatment-naïve or Untreated for at Least 6 Months
Protocol code: EFC17045 - PERIDOT
Sponsor: Sanofi-Aventis Recherche & Developpement (Pharmaceutical company). Phase: Therapeutic confirmatory (Phase III). Countries: Norway (ongoing, recruitment ended), Poland (ongoing, recruitment ended), France (ongoing, recruitment ended), Romania (ongoing, recruitment ended), Italy (ongoing, recruitment ended), Germany (ongoing, recruitment ended), Greece (ongoing, recruitment ended), Austria (ended), Denmark (ongoing, recruitment ended), Finland (ongoing, recruitment ended).
Therapeutic area(s): Diseases [C] - Congenital, Hereditary, and Neonatal Diseases and Abnormalities [C16]
Gender: Female, Male. Age: 0-17 years, 18-64 years, 65+ years. Enrolment: 48.
Start date (EU): 2022-06-28. Decision date: 2024-06-19. Results received: No. Last updated: 2026-06-08.
Decision dates by country: AT: 2024-06-24, GR: 2024-09-09, IT: 2024-07-01, PL: 2024-07-26, FI: 2024-06-20, DK: 2024-06-19, RO: 2024-06-26, DE: 2024-06-20, FR: 2024-06-20, NO: 2024-06-20

Condition(s): Fabry Disease
Product: Placebo 6mg tablets, venglustat GZ402671 - SAR402671, venglustat GZ402671 - SAR402671, Placebo 15mg Tablets

Primary endpoint: Percent change from baseline at 6 months in the most bothersome symptom of 3 Fabry Disease Patient-Reported Outcome (FD-PRO) items (neuropathic pain in upper extremities, neuropathic pain in lower extremities, or abdominal pain), Percent change from baseline at 12 months in the most bothersome symptom of 3 Fabry Disease Patient-Reported Outcome (FD-PRO) items (neuropathic pain in upper extremities, neuropathic pain in lower extremities, or abdominal pain)
Endpoint(s): Percent change in plasma globotriaosylsphingosine (lyso-GL-3), Frequency of rescue pain medication use, Change in the percentage of days with at least 1 stool reflecting diarrhea (Bristol Stool Form Scale [BSFS] Type 6 or 7), Change in tiredness component of FD-PRO, Proportion of responders in neuropathic or abdominal pain, as assessed by FD-PRO, Number of participants with adverse event (AE) and serious adverse event (SAE), Change in the lens clarity (new or worsening lens opacities) by ophthalmological examination (by slit lamp exam at Visit 2 and Visit 6), Change in Beck Depression Inventory-II (BDI-II) score, Plasma venglustat concentrations at prespecified visits over the study duration, Maximum venglustat plasma concentration (Cmax), Time to maximum venglustat plasma concentration (tmax), Area under the venglustat plasma concentration versus time curve from time 0 to 24 hours (AUC0-24)

Source: https://euclinicaltrials.eu/ctis-public/view/2024-511990-31-00